EU clinical trial 2023-508125-27-00: Esketamine nasal spray (Spravato) for the treatment of therapy-resistant bipolar depression. An open-label pilot trial.
Sponsor: Academisch Ziekenhuis Leiden (Hospital/Clinic/Other health care facility). Phase: Therapeutic exploratory (Phase II). Countries: Netherlands (ongoing, recruiting).
Therapeutic area(s): Psychiatry and Psychology [F] - Mental Disorders [F03]
Gender: Female, Male. Age: 18-64 years, 65+ years. Enrolment: 20.
Status: Ongoing, recruiting. Start date (EU): 2025-04-01. Decision date: 2024-11-26. Results received: No. Last updated: 2024-11-26.

Condition(s): Bipolar disorder- depressive episode
Product: Spravato 28 mg nasal spray, solution

Primary endpoint: Efficacy as determined by response and remission rates: response is defined as a 50% or more reduction of the MADRS score. Remission is defined as a MADRS score that falls under ten.
Endpoint(s): Safety will be determined by the number of side effects. The potential effect of conversion to mania will be measured by a YMRS of 20 or more points, indicating at least a mild mania. All other psychiatric side effects, such as psychosis and suicidality as well as somatic side effects will be meticulously monitored., Tolarability will be determined by dropout rates during the whole study., Relapse will be monitored and measured by: admission to a psychiatric hospital or ward due to depressive symptoms; a suicide attempt or admission to prevent suicide; an increase in depressive symptoms measured by the MADRS of >25% or above 22 points after initial response or remission following treatment.

Source: https://euclinicaltrials.eu/ctis-public/view/2023-508125-27-00